EU clinical trial 2024-518156-24-00: INCB018424-316: A Phase 3b, Double-Blind, Multicenter, Randomized, Vehicle-Controlled, Efficacy and Safety Study of Ruxolitinib Cream in Children and Adolescents (6 to < 18 Years Old) With Moderate Atopic Dermatitis
Protocol code: INCB018424-316
Sponsor: Incyte Corp. (Pharmaceutical company). Phase: Therapeutic confirmatory (Phase III). Countries: France (ongoing, recruitment ended), Germany (ongoing, recruitment ended), Spain (ongoing, recruitment ended), Belgium (ongoing, recruitment ended), Italy (ongoing, recruitment ended), Hungary (ongoing, recruitment ended), Poland (ongoing, recruitment ended).
Therapeutic area(s): Diseases [C] - Skin and Connective Tissue Diseases [C17]
Gender: Female, Male. Age: 0-17 years. Enrolment: 111.
Status: Ongoing, recruitment ended. Start date (EU): 2025-11-10. Decision date: 2025-09-18. Results received: No. Last updated: 2026-07-06.
Decision dates by country: ES: 2025-09-26, HU: 2025-09-26, FR: 2025-09-18, DE: 2025-09-22, IT: 2025-09-19, PL: 2025-09-27, BE: 2025-09-23

Condition(s): Atopic Dermatitis
Product: Ruxolitinib (INCB018424) cream, Vehicle cream: same formulation of cream as the test product but without active substance and phosphoric acid

Primary endpoint: The binary response status of EASI75 at VC Week 8. (EASI75 response is defined as achieving ≥ 75% improvement in EASI score from baseline.)
Endpoint(s): The binary response status of IGA-TS at VC Week 8. (IGA-TS response is defined as achieving an IGA score of 0 or 1 with ≥ 2-grade improvement from baseline.), The binary response status of ITCH4 at VC Week 8. (ITCH4 response is defined as achieving ≥ 4-point improvement in Itch NRS [participants aged 12 to < 18 years] or WI NRS [participants aged 6 to < 12 years] score from baseline.), Time to first DE in the DC period. (Defined as responders [IGA score < 2] from the VC period or the OLE period rerandomized to proactive treatment, time to first DE, where DE is defined as IGA score of ≥ 2.), The type, frequency, and severity of AEs and changes in vital signs, height, weight, and laboratory data for hematology and serum chemistry., The binary response status of EASI75 at each postbaseline visit except VC Week 8., The binary response status of IGA-TS at each postbaseline visit except VC Week 8., The binary response status of ITCH4 at Days 2, 3, and 7 and VC Weeks 2 and 4., Time to achieve ITCH4 during the VC period., The binary response status of both EASI75 and IGA-TS at each postbaseline visit in the VC period., The binary response status of DLQI-4 (or CDLQI-4) at VC Weeks 2, 4, and 8 (DLQI-4 (or CDLQI-4) is defined as achieving ≥ 4-point improvement in DLQI (or CDLQI) from baseline.), Change from baseline at each postbaseline visit in the VC period and DC period for the following: − DLQI (or CDLQI) score − POEM score, Acceptability and tolerability assessment (exit interview/questionnaire), Number of DEs during the DC period., Amount of ruxolitinib cream used during the DC period., Plasma concentrations of ruxolitinib and PK parameters (Ctrough,ss) at VC Week 2 and VC Week 8 assessed in at least 10 evaluable ruxolitinib-treated participants in each of the 12 to < 18 year old and 6 to < 12 years old age groups.

Source: https://euclinicaltrials.eu/ctis-public/view/2024-518156-24-00